EU clinical trial 2025-523662-24-00: Phase 3 Single-Arm Open-Label Study to Evaluate the Efficacy and Safety of Zodasiran in Adolescent Subjects (age 12 to <18 years) with Homozygous Familial Hypercholesterolemia (SPRUCE)
Protocol code: AROANG3-3003
Sponsor: Arrowhead Pharmaceuticals Inc. (Pharmaceutical company). Phase: Therapeutic confirmatory (Phase III). Countries: Netherlands (authorised, recruitment pending), Denmark (authorised, recruitment pending), Norway (authorised, recruitment pending), Sweden (authorised, recruitment pending), Poland (authorised, recruitment pending).
Therapeutic area(s): Diseases [C] - Cardiovascular Diseases [C14]
Gender: Female, Male. Age: 0-17 years, 18-64 years. Enrolment: 9.
Status: Authorised, recruitment pending. Decision date: 2026-07-20. Results received: No. Last updated: 2026-07-31.
Decision dates by country: DK: 2026-07-20, SE: 2026-07-21, NO: 2026-07-24, PL: 2026-07-27, NL: 2026-07-20

Condition(s): Homozygous Familial Hypercholesterolemia (HoFH)
Product: ARO-ANG3

Primary endpoint: Percent Change from Baseline to Month 12 in Fasting LDL-C
Endpoint(s): 1. Percent Change from Baseline to Month 12 in Fasting Apolipoprotein B (ApoB), 2. Percent Change from Baseline to Month 12 in in Fasting Non-High Density Lipoprotein Cholesterol (non-HDL-C), 3. Change from Baseline to Month 12 in Fasting LDL-C, 4. Area Under the Plasma Concentration Versus the Time Curve (AUC) from Baseline to Month 12 for Fasting LDL-C, 5. Percent Change from Baseline to Month 12 in Fasting Triglycerides (TGs), 6. Percent Change from Baseline to Month 12 in Fasting Angiopoietin-like Protein 3 (ANGPTL3), 7. Percent Change from Baseline to Month 12 in Fasting Total Cholesterol, 8. Percent Change from Baseline to Month 12 in in Fasting HDL-C, 9. Number of Participants who Meet European Union (EU) LDL-C Apheresis Eligibility Criteria (per German Apheresis Working Group) at Month 12, 10. Number of Participants who Meet United States (US) Apheresis Eligibility Criteria (per National Lipid Association) at Month 12, 11. Number of Participants with Fasting LDL-C <100 mg/dL at Month 12, 12. Change from Baseline in Fasting LDL-C Over Time, 13. Percent Change from Baseline in Fasting LDL-C Over Time, 14. Number of Participants with Treatment-Emergent Adverse Events (TEAEs)

Source: https://euclinicaltrials.eu/ctis-public/view/2025-523662-24-00